EU clinical trial 2025-523950-15-01: A Phase 2, Multicenter, Randomized, Double-Blind, Placebo-Controlled Study With a Long-term Extension of Povetacicept in Adults with Generalized Myasthenia Gravis
Protocol code: VX25-AIS-301
Sponsor: Vertex Pharmaceuticals Inc. (Pharmaceutical company). Phase: Therapeutic exploratory (Phase II). Countries: Poland (ongoing, recruiting).
Therapeutic area(s): Diseases [C] - Nervous System Diseases [C10]
Gender: Female, Male. Age: 18-64 years, 65+ years. Enrolment: 5.
Status: Ongoing, recruiting. Start date (EU): 2026-05-29. Decision date: 2026-05-29. Results received: No. Last updated: 2026-05-29.

Condition(s): Generalized Myasthenia Gravis
Product: Test IMP without active substance, ALPN-303 solution for injection in pre-filled syringe

Primary endpoint: Phase 2: Percent change in total immunoglobulin G (IgG) [Time Frame: Baseline and At Week 12], Phase 2 and LTE: Safety and tolerability as Assessed by Number of Participants with Adverse Events (AEs) and Serious Adverse Events (SAEs)

Source: https://euclinicaltrials.eu/ctis-public/view/2025-523950-15-01